EU clinical trial 2023-505910-10-00: A Multicenter, Open-Label Clinical Trial of RVU120 in Patients with Relapsed or Refractory High-Risk Myelodysplastic Syndrome or Acute Myeloid Leukemia with or without NPM1 Mutation (RIVER-52)
Protocol code: River-52
Sponsor: Ryvu Therapeutics S.A. (Pharmaceutical company). Phase: Therapeutic exploratory (Phase II). Countries: Italy (ended), Poland (ended), France (ended), Spain (ended).
Therapeutic area(s): Diseases [C] - Neoplasms [C04]
Gender: Female, Male. Age: 18-64 years, 65+ years. Enrolment: 174.
Status: Ended. Start date (EU): 2024-01-23. End date (EU): 2025-08-27. Decision date: 2023-12-21. Results received: No. Last updated: 2025-08-19.
Decision dates by country: PL: 2023-12-21, IT: 2023-12-29, FR: 2024-09-02, ES: 2024-09-05

Condition(s): Relapsed or Refractory High-Risk Myelodysplastic Syndrome, Acute Myeloid Leukemia with or without NPM1 Mutation
Product: SEL120 monohydrochloride, SEL120 monohydrochloride

Primary endpoint: Rate of CR
Endpoint(s): Overall response rate (ORR) including clinical benefit beyond CR • Duration of response (DoR) • Transfusion independence and/or hematological improvement • 1-year progression-free survival (PFS) • 1-year relapse-free survival (RFS) • 1-year overall survival (OS) • Percentage of participants bridged to hematopoietic stem cell transplantation (HSCT), Incidence and severity of AE, PK of RVU120 including, data permitting, Cmax, tmax, AUCtau, AUCinf ax, AUC, and t½, Part 2 only: Changes in patient-reported outcomes as assessed by changes in summary scores of the HM-PRO and QOL-E, Rate of measurable residual disease (MRD) negativity

Source: https://euclinicaltrials.eu/ctis-public/view/2023-505910-10-00